EU clinical trial 2025-523254-14-00: Research into the safety of a new agent (AX-5006) in people with and without Parkinson's disease.
Protocol code: AXL-5006-101
Sponsor: Vertero Therapeutics Inc. (Pharmaceutical company). Phase: Human Pharmacology (Phase I)- First administration to humans. Countries: Netherlands (ongoing, recruiting).
Therapeutic area(s): Diseases [C] - Nervous System Diseases [C10]
Gender: Female, Male. Age: 18-64 years, 65+ years. Enrolment: 108.
Status: Ongoing, recruiting. Start date (EU): 2025-10-27. Decision date: 2025-10-27. Results received: No. Last updated: 2026-08-04.

Condition(s): Parkinson's disease

Source: https://euclinicaltrials.eu/ctis-public/view/2025-523254-14-00